EU clinical trial 2025-522873-12-00: A phase 3 randomized, double-blind, active-controlled study of palazestrant with ribociclib versus letrozole with ribociclib for the first-line treatment of ER+, HER2- advanced breast cancer (OPERA-02)
Protocol code: OP-1250-302
Sponsor: Olema Pharmaceuticals Inc. (Pharmaceutical company). Phase: Therapeutic confirmatory (Phase III). Countries: Hungary (ongoing, recruiting), Portugal (ongoing, recruiting), Italy (ongoing, recruiting), France (ongoing, recruiting), Poland (ongoing, recruiting), Czechia (ongoing, recruiting), Germany (ongoing, recruiting), Spain (ongoing, recruiting), Belgium (ongoing, recruiting), Austria (ongoing, recruiting), Romania (ongoing, recruiting), Greece (ongoing, recruiting), Netherlands (ongoing, recruiting).
Therapeutic area(s): Diseases [C] - Neoplasms [C04]
Gender: Female, Male. Age: 18-64 years, 65+ years. Enrolment: 384.
Status: Ongoing, recruiting. Start date (EU): 2026-02-24. Decision date: 2026-02-17. Results received: No. Last updated: 2026-06-22.
Decision dates by country: IT: 2026-02-17, DE: 2026-02-19, AT: 2026-02-20, NL: 2026-02-17, GR: 2026-02-17, PT: 2026-02-20, PL: 2026-02-22, CZ: 2026-02-17, HU: 2026-02-23, RO: 2026-02-23, ES: 2026-02-18, FR: 2026-02-17, BE: 2026-02-17

Condition(s): ER+, HER2- Advanced Breast Cancer
Product: Palazestrant matching placebo tablets and Letrozole matching placebo capsules, Palazestrant, RIBOCICLIB, Palazestrant, LETROZOLE, Palazestrant

Primary endpoint: Local Investigator-assessed PFS (Progression-Free Survival)
Endpoint(s): 1. OS, 2. BIRC-assessed PFS, ORR, DOR and CBR, 3. Local Investigator-assessed ORR, DOR, CBR, 4. Safety and tolerability, assessed by AEs, SAEs, dose modifications, clinical laboratory parameters, ECGs, performance status, and vital sign measurements, 5. Plasma levels of palazestrant and ribociclib (in investigational arm) and of ribociclib (in control arm) at predefined intervals to establish PK parameters., 6. PRO endpoints, assessed using the EORTC QLQ- C30, EORTC QLQ-BR42 and EQ-5D-5L questionnaires, 7. Time from randomization to disease progression on first subsequent systemic anti-cancer therapy or death

Source: https://euclinicaltrials.eu/ctis-public/view/2025-522873-12-00